EU clinical trial 2024-511933-36-00: A randomized, double-blind, parallel group, placebo-controlled multicenter study to evaluate efficacy, safety and tolerability of ianalumab in participants with diffuse cutaneous systemic sclerosis
Protocol code: CVAY736S12201
Sponsor: Novartis Pharma AG (Pharmaceutical company). Phase: Therapeutic exploratory (Phase II). Countries: France (ongoing, recruiting), Greece (ongoing, recruiting), Portugal (ongoing, recruiting), Hungary (ongoing, recruiting), Italy (ongoing, recruiting), Germany (ongoing, recruiting), Spain (ongoing, recruiting), Belgium (ongoing, recruiting), Poland (ongoing, recruitment ended), Austria (ongoing, recruiting).
Therapeutic area(s): Diseases [C] - Immune System Diseases [C20]
Gender: Female, Male. Age: 18-64 years, 65+ years. Enrolment: 62.
Start date (EU): 2025-01-02. Decision date: 2024-10-21. Results received: No. Last updated: 2026-04-20.
Decision dates by country: PL: 2024-10-28, BE: 2024-10-21, DE: 2024-10-24, PT: 2024-10-24, ES: 2024-10-21, HU: 2024-10-22, FR: 2025-01-16, IT: 2024-12-17, AT: 2024-10-25, GR: 2024-10-22

Condition(s): Diffuse cutaneous systemic sclerosis (dcSSc)
Product: ENTECAVIR, Placebo to VAY736 150 mg/1 mL Solution for injection in pre-filled syringe, TENOFOVIR DISOPROXIL, TENOFOVIR ALAFENAMIDE, VAY736

Primary endpoint: 3/5 rCRISS25 response at Week 52
Endpoint(s): Change from baseline in FVC% predicted at Week 52., Change from baseline in mRSS at Week 52., Change from baseline in HAQ-DI at Week 52., Ianalumab concentrations in serum during treatment and Follow-up Period, Incidence and titer of anti-drug (ianalumab) antibodies (ADAs) in serum over time, Safety evaluation includes adverse events, laboratory parameters, and vital signs

Source: https://euclinicaltrials.eu/ctis-public/view/2024-511933-36-00